EU clinical trial 2024-517110-15-00: Preoperative Lugol’s solution in Graves’ disease and toxic nodular goiter
Protocol code: LugolProtocol001
Sponsor: Karolinska University Hospital (Hospital/Clinic/Other health care facility). Phase: Therapeutic confirmatory (Phase III). Countries: Sweden (ongoing, recruiting).
Therapeutic area(s): Diseases [C] - Hormonal diseases [C19]
Gender: Female, Male. Age: 18-64 years, 65+ years. Enrolment: 182.
Status: Ongoing, recruiting. Start date (EU): 2024-08-15. Decision date: 2024-08-15. Results received: No. Last updated: 2024-08-15.

Condition(s): Hyperthyroidism

Primary endpoint: Pilot study: Response of TSH, fT4, fT3 and heart rate after 10 days of administration of iodine solution. Main study: Occurance of postoperative temporary hypoparathyroidism. Pilot study: Serum levels of TSH, fT4, fT3 and heart rate day 0, day 3-4, day 6-7 and day 10 after administration of iodine solution. Main study: Immediately postoperatively and 1 month post surgery
Endpoint(s): Pilot study: evaluation of quality of life after treatment with iodine solution. Main study: Occurance of postoperative permanent hypoparathyroidism. Occurance of postoperative temporary and permanent recurrant nerve palsy. Evaluation of quality of Life.

Source: https://euclinicaltrials.eu/ctis-public/view/2024-517110-15-00